EU clinical trial 2023-505497-14-00: A Phase 2, Open-Label, Single-Arm, Cohort Study to Evaluate the Safety, Efficacy, and Pharmacokinetics of Sparsentan Treatment in Pediatric Subjects with Selected Proteinuric Glomerular Diseases (EPPIK)
Protocol code: RTRX-RE021-201
Sponsor: Travere Therapeutics Inc. (Pharmaceutical company). Phase: Therapeutic exploratory (Phase II). Countries: Poland (ongoing, recruiting), Germany (ongoing, recruiting), Sweden (ongoing, recruiting), Netherlands (ongoing, recruiting), Italy (ongoing, recruiting), Spain (ongoing, recruiting).
Therapeutic area(s): Diseases [C] - Pathological Conditions, Signs and Symptoms [C23]
Gender: Female, Male. Age: 0-17 years. Enrolment: 27.
Status: Ongoing, recruiting. Start date (EU): 2021-12-09. Decision date: 2024-06-24. Results received: No. Last updated: 2026-05-22.
Decision dates by country: IT: 2024-07-03, SE: 2024-06-24, PL: 2024-07-15, ES: 2024-06-26, NL: 2024-06-25, DE: 2024-06-26

Condition(s): Proteinuric glomerular diseases including: •Focal segmental glomerulosclerosis (FSGS); •Minimal change disease (MCD); •Immunoglobulin A nephropathy (IgAN); •Immunoglobulin A vasculitis (IgAV); •Alport syndrome (AS)
Product: Sparsentan_DF3, Sparsentan_DF2, Sparsentan_DF4

Primary endpoint: The incidence of treatment-emergent adverse events (TEAEs), serious adverse events (SAEs), adverse events (AEs) leading to treatment discontinuation, and adverse events of interest (AEOIs), Change from baseline in urine protein/creatinine ratio (UP/C) over 108 weeks
Endpoint(s): Observed plasma PK concentrations at scheduled timepoints and visits, Relevant steady-state PK parameters (area under the plasma concentration-time curve during a dosing interval [AUCτ], maximum steady-state plasma drug concentration [Cmax_ss], and minimum steady-state plasma drug concentration [Cmin_ss]), Change from baseline in urine albumin/creatinine ratio (UA/C) and eGFR over 108 weeks, The proportion of subjects achieving complete remission of proteinuria, defined as UP/C <0.3 g/g, over 108 weeks, The proportion of subjects with focal segmental glomerulosclerosis (FSGS) and/or minimal change disease (MCD) histological patterns achieving partial remission, defined as UP/C ≤1.5 g/g and >40% reduction in UP/C over 108 weeks, The proportion of subjects who discontinue study medication due to inability to tolerate the smell, taste, aftertaste, volume of administration, or method of administration of the oral suspension (Population 1 and Population 2).

Source: https://euclinicaltrials.eu/ctis-public/view/2023-505497-14-00